EU clinical trial 2024-512043-22-00: ReaLuP : an open label, single arm phase IIb study of re-treatment with [177Lu]Lu-PSMA in men with metastatic castration resistance prostate cancer
Protocol code: 69HCL24_0183
Sponsor: Hospices Civils De Lyon (Hospital/Clinic/Other health care facility). Phase: Therapeutic exploratory (Phase II). Countries: France (ongoing, recruiting).
Therapeutic area(s): Diseases [C] - Neoplasms [C04]; Diseases [C] - Male Urogenital Diseases [C12]
Gender: Male. Age: 18-64 years, 65+ years. Enrolment: 58.
Status: Ongoing, recruiting. Start date (EU): 2025-04-11. Decision date: 2025-03-04. Results received: No. Last updated: 2026-02-11.

Condition(s): Metastatic prostate cancer
Product: Pluvicto 1 000 MBq/mL solution for injection/infusion, Locametz 25 micrograms kit for radiopharmaceutical preparation

Primary endpoint: Percentage of patients with radiological progression free survival (based on RECIST 1.1 or PCWG3 criteria) at 24 weeks from the first day of study treatment administration, assessed with imaging (bone scan and CT-scan).
Endpoint(s): EFFICACY : Imaging base radiographic progression (rPFS) defined as the time from the first cycle of [177Lu]Lu-PSMA-617 re-treatment to the date of radiographic disease progression as outlined in Prostate Cancer Working Group 3 (PCWG3) Guidelines or death from any cause., EFFICACY: Overall survival defined as the time from the first cycle of [177Lu]Lu-PSMA-617 re-treatment to the date of death from any cause, EFFICACY : RECIST response including: i.Objective response rate (ORR) (CR + PR) as measured by RECIST v1.1 response in soft tissue, lymph node and visceral lesions. Duration of Response (DOR) will also be measured in patients with a CR or PR from date of first response to the date of RECIST progression or death. ii.Disease Control Rate (DCR) (CR + PR + stable disease [SD]) as measured by RECIST v1.1 response in soft tissue, lymph node and visceral lesions., EFFICACY : Progression-free survival defined as the date of first cycle of [177Lu]Lu-PSMA-617 re-treatment to the date of first evidence of radiographic progression, clinical progression, PSA progression, or death from any cause, whichever occurs first., EFFICACY : Biological response endpoints: Proportion of participants with a PSA response defined as a patient who has achieved a ≥ 50% PSA decrease from baseline that is confirmed with a second PSA measurement at ≥ 4 weeks., EFFICACY : Time to PSA progression defined as the date from first cycle of [177Lu]Lu-PSMA-617 re-treatment to a ≥25% increase in PSA and an absolute increase of 2ng/mL or more from the nadir and confirmed by a second consecutive value obtained 3 or more weeks later., SAFETY : Percentage of patients with all grade and Serious AEs (SAEs), SAFETY : Percentage of patients with Serious AEs (SAEs) during the active follow-up period, SAFETY : Percentage of patients with an interruption of [177Lu]Lu-PSMA-617 re-treatment, SAFETY : Percentage of patients who discontinue [177Lu]Lu-PSMA-617 re-treatment secondary to an AEs or death, SAFETY : Number and grade of AE related to the investigational medicinal product or to the procedures added by the research, QUALITY of LIFE: Pain assessed with the BPI-SF questionnaire., QUALITY of LIFE : Time to first symptomatic skeletal event (SSE) and SSE-free survival defined as date of first injection of [177Lu]Lu-PSMA-617 re-treatment to the date of first new symptomatic pathological bone fracture, spinal cord compression, tumor-related orthopedic surgical intervention, or requirement for radiation therapy to relieve bone pain, whichever occurs first., QUALITY of LIFE : Aspects of HRQoL will be reported using Functional Assessment of Cancer Therapy – Prostate [FACT-P] questionnaire, Sub-group analyses : To assess radiological PFS at 24 weeks on the following subgroups of patients on the primary outcome: o Patients with concordant results at screening on both 18F-FDG-PET/CT and [68Ga]-PSMA-PET/CT vs o Patients with discordant results on those exams at screening: 18F-FDG-PET/CT positive lesions with no uptake on [68Ga]-PSMA-PET/CT.

Source: https://euclinicaltrials.eu/ctis-public/view/2024-512043-22-00